EU clinical trial 2024-516962-13-00: A multicenter, double-blind, randomized study to evaluate the effects of tasimelteon vs. placebo in participants with Delayed Sleep-Wake Phase Disorder (DSWPD)
Protocol code: VP-VEC-162-3502
Sponsor: Vanda Pharmaceuticals Inc. (Pharmaceutical company). Phase: Therapeutic confirmatory (Phase III). Countries: Austria (ended), Germany (ongoing, recruitment ended).
Therapeutic area(s): Diseases [C] - Nervous System Diseases [C10]
Gender: Female, Male. Age: 18-64 years, 65+ years. Enrolment: 28.
Start date (EU): 2022-09-23. Decision date: 2024-11-13. Results received: No. Last updated: 2026-07-14.
Decision dates by country: AT: 2024-11-25, DE: 2024-11-13

Condition(s): Delayed Sleep-Wake Phase Disorder (DSWPD)
Product: HETLIOZ 20 mg hard capsules, Placebo will be provided in size and appearance identical to those containing tasimelteon and will be administered orally.

Primary endpoint: To assess the effects of a daily single oral dose of 20 mg tasimelteon compared to placebo on Sleep Onset (change from baseline) in participants over a 28-day period, as measured by sleep diary.
Endpoint(s): To assess the effects of 20 mg tasimelteon compared to placebo on Sleep Onset (change from baseline) during the treatment phase, as measured by actigraphy., To assess the effects of 20 mg tasimelteon compared to placebo on nighttime subjective sleep parameters such as SOL, wake time, midpoint of sleep, and total sleep time (change from baseline), as measured by sleep diary., To assess the effects of 20 mg tasimelteon compared to placebo on nighttime objective sleep parameters such as SOL, wake time, midpoint of sleep, and total sleep time (change from baseline), as measured by actigraphy., To assess the effects of 20 mg tasimelteon compared to placebo on subjective sleep-related impairments and subjective sleep disturbances, as measured by PROMIS., To assess the effects of 20 mg tasimelteon compared to placebo on global improvement and severity, as measured by CGI-C, PGI-C, and PGI-S., To assess the effects of 20 mg tasimelteon compared to placebo on the change in circadian phase from baseline to post-treatment, as measured by salivary DLMO., To assess the effects of 20 mg tasimelteon on Sleep Onset (change from baseline) in participants with delayed DLMO compared to participants with non-delayed DLMO, as measured by sleep diary., To assess the effects of 20 mg tasimelteon on Sleep Onset (change from baseline) in participants with PER3 rs57875989 (specifically genotype 4/4 and 4/4+4/5), as measured by sleep diary., To assess the safety and tolerability of a daily single oral dose of 20 mg tasimelteon.

Source: https://euclinicaltrials.eu/ctis-public/view/2024-516962-13-00